EU clinical trial 2025-523686-15-00: Phase 1 Study of OP-3136 in Advanced or Metastatic Solid Tumors
Protocol code: OP-3136-101
Sponsor: Olema Pharmaceuticals Inc. (Pharmaceutical company). Phase: Human Pharmacology (Phase I)- First administration to humans. Countries: Ireland (ongoing, recruiting), Spain (ongoing, recruiting), France (ongoing, recruiting).
Therapeutic area(s): Diseases [C] - Neoplasms [C04]
Gender: Female, Male. Age: 18-64 years, 65+ years. Enrolment: 48.
Status: Ongoing, recruiting. Start date (EU): 2026-04-08. Decision date: 2026-03-17. Results received: No. Last updated: 2026-07-20.
Decision dates by country: ES: 2026-03-17, FR: 2026-03-18, IE: 2026-03-20

Condition(s): Advanced or Metastatic Solid Tumors

Source: https://euclinicaltrials.eu/ctis-public/view/2025-523686-15-00